EU clinical trial 2026-525895-25-00: A randomized, placebo-controlled, blinded, parallel-group clinical trial to assess the efficacy of N-acetylcysteine in adults with acute infections or sepsis and evidence of liver dysfunction: the IMPACT-NAC trial
Sponsor: Region Hovedstaden (Hospital/Clinic/Other health care facility). Phase: Therapeutic use (Phase IV). Countries: Denmark (authorised, recruitment pending).
Therapeutic area(s): Diseases [C] - Bacterial Infections and Mycoses [C01]; Diseases [C] - Virus Diseases [C02]
Gender: Female, Male. Age: 18-64 years, 65+ years. Enrolment: 360.
Status: Authorised, recruitment pending. Decision date: 2026-05-22. Results received: No. Last updated: 2026-05-22.

Condition(s): Acute infection, Sepsis
Product: ACETYLCYSTEINE, SODIUM CHLORIDE

Primary endpoint: Days alive and out of hospital from randomization to day 14
Endpoint(s): Number of participants with one or more serious adverse event within 14 days of randomization, All-cause mortality at day 180, Health-related quality of life (HRQoL) at day 180 using EQ-5D-5L index values, Admission to an intensive care unit (ICU) within 14 days of admission, Duration of antibiotic therapy from randomization to day 14, Time to clinical stability, Days alive and out of hospital from randomization to day 180

Source: https://euclinicaltrials.eu/ctis-public/view/2026-525895-25-00